EU clinical trial 2024-515937-13-00: Multicenter, randomized, double-blind, placebo controlled study to assess the efficacy and safety of RApamycin in drug Resistant Epilepsy associated with TSC
Protocol code: RaRE-TS
Sponsor: Instytut Pomnik Centrum Zdrowia Dziecka (Hospital/Clinic/Other health care facility). Phase: Therapeutic confirmatory (Phase III). Countries: Poland (ongoing, recruiting).
Therapeutic area(s): Diseases [C] - Nervous System Diseases [C10]
Gender: Female, Male. Age: 0-17 years, 18-64 years. Enrolment: 200.
Status: Ongoing, recruiting. Start date (EU): 2023-02-07. Decision date: 2024-12-20. Results received: No. Last updated: 2026-03-09.

Condition(s): tuberous sclerosis complex, epilepsy, organ tumors associated with tuberous sclerosis
Product: Rapamune 1 mg/mL oral solution, Linseed oil

Primary endpoint: comparison of the number of patients with at least 50% reduction of seizures per week in the last month of the core blinded phase in comparison to screening phase in the rapamycin vs placebo group (, number of adverse events (according to CTCAE classification) in the rapamycin vs placebo group during the double-blind core phase
Endpoint(s): comparison of the number of seizures per week and the number of days free of seizures in the rapamycin vs placebo group, during 12-week treatment in double-blind core phase, severity of adverse events (according to CTCAE) and the number of patients withdrawn from the study due to adverse events in the rapamycin vs placebo group

Source: https://euclinicaltrials.eu/ctis-public/view/2024-515937-13-00